EU clinical trial 2025-522397-36-00: Study of GS-5319 in Adults With Solid Tumors
Protocol code: GS-US-707-7297
Sponsor: Gilead Sciences Inc. (Pharmaceutical company). Phase: Human Pharmacology (Phase I)- First administration to humans. Countries: Spain (authorised, recruiting).
Therapeutic area(s): Diseases [C] - Neoplasms [C04]
Gender: Female, Male. Age: 18-64 years, 65+ years. Enrolment: 35.
Status: Authorised, recruiting. Start date (EU): 2025-12-18. Decision date: 2025-11-24. Results received: No. Last updated: 2026-01-28.

Condition(s): Advanced solid tumors

Source: https://euclinicaltrials.eu/ctis-public/view/2025-522397-36-00